EU clinical trial 2025-523061-22-00: A Phase II, Open-Label, Single-Center, Single-Arm Pilot Study to Evaluate the Safety, Tolerability and Efficacy of Blinatumomab for Treatment of Patients with Autoimmune B-Cell driven Diseases including Systemic Lupus Erythematosus (SLE), Systemic Sclerosis (SSc) and Granulomatous Polyangiitis (GPA)
Protocol code: BlinA-B
Sponsor: Universitaet Leipzig (Educational Institution). Phase: Therapeutic exploratory (Phase II). Countries: Germany (ongoing, recruiting).
Therapeutic area(s): Diseases [C] - Immune System Diseases [C20]
Gender: Female, Male. Age: 18-64 years, 65+ years. Enrolment: 5.
Status: Ongoing, recruiting. Start date (EU): 2025-11-14. Decision date: 2025-09-26. Results received: No. Last updated: 2026-03-25.

Condition(s): Granulomatous Polyangiitis, Systemic Lupus Erythematosus, Systemic Sclerosis
Product: BLINCYTO 38.5 micrograms powder for concentrate and solution for solution for infusion.

Primary endpoint: Incidence of treatment-emergent adverse events (adverse events up to week 12)
Endpoint(s): Incidence of treatment-emergent adverse events (adverse events from week 13 up to week 52), Reduction of Titers of significant autoantibodies such as anti-ds DNA antibodies, SCL-70 antibodies or Pr3 antibodies, Clinical efficacy (Selena SLEDAI in SLE patients, ACR-CRISS score in cutaneous SSc patients, BVAS Score in GPA patients)

Source: https://euclinicaltrials.eu/ctis-public/view/2025-523061-22-00